EU clinical trial 2024-511042-39-00: REVERSE: a randomized controlled trial (RCT) to ameliorate treatment-resistant Post Traumatic Stress Disorder (PTSD) with Glucocorticoid Receptor (GR) antagonism
Protocol code: REVERSE
Sponsor: Amsterdam UMC (Hospital/Clinic/Other health care facility). Phase: Therapeutic exploratory (Phase II). Countries: Netherlands (ongoing, recruiting).
Therapeutic area(s): Psychiatry and Psychology [F] - Mental Disorders [F03]
Gender: Female, Male. Age: 18-64 years. Enrolment: 60.
Status: Ongoing, recruiting. Start date (EU): 2024-11-13. Decision date: 2024-04-19. Results received: No. Last updated: 2026-02-24.

Condition(s): Post-traumatic stress disorder (PTSD)
Product: MIFEPRISTONE, PLACEBO

Primary endpoint: To investigate whether mifepristone (7-day, 1200 mg/day) is more efficacious than placebo in reducing PTSD symptom severity 4 weeks after the start of the intervention, as measured with the monthly version of the CAPS-5 (Clinician Administered PTSD scale) in patients with treatment-resistant PTSD.
Endpoint(s): PTSD symptom severity as measured with the weekly version of the PCL-5, from baseline till 12 weeks after the start of the intervention (T3)., Long-term PTSD symptom severity as measured with the CAPS-5, at 12 weeks after the start of the intervention (T3)., Loss of diagnosis (score of <26 and absence of PTSD criteria with CAPS-5), 4 weeks after the start of the intervention., Treatment response (minimum decrease of 10 point on the PCL-5 and CAPS-5 scores) at 1, 4 and 12 weeks after the start of the intervention., Other clinical outcomes 1, 4, and 12 weeks after the start the intervention: o disability (WHO Disability Schedule 2.0; WHO-DAS II), o sleep (Insomnia Severity Index; ISI), o subjective stress (Perceived Stress Scale; PSS), o anxiety symptoms (Beck Anxiety Inventory; BAI), o depressive symptoms (IDS-SR), o suicidal ideation and behaviour (Columbia-Suicide Severity Rating Scale).

Source: https://euclinicaltrials.eu/ctis-public/view/2024-511042-39-00